EU clinical trial 2024-517431-43-00: J1I-MC-GZQD: A Phase 3 Randomized, Double-Blind, Placebo-Controlled Study to Investigate the Efficacy and Safety of Retatrutide Once Weekly in Participants Who Have Obesity or Overweight and Chronic Low Back Pain (TRIUMPH-7)
Protocol code: J1I-MC-GZQD
Sponsor: Eli Lilly & Co. (Pharmaceutical company). Phase: Therapeutic confirmatory (Phase III). Countries: Poland (ended).
Therapeutic area(s): Diseases [C] - Musculoskeletal Diseases [C05]
Gender: Female, Male. Age: 18-64 years, 65+ years. Enrolment: 85.
Status: Ended. End date (EU): 2025-10-06. Decision date: 2025-04-06. Results received: No. Last updated: 2025-09-12.

Condition(s): Overweight, Chronic Low Back Pain (CLBP), Obesity
Product: Placebo to match LY, Retatrutide, Retatrutide, Retatrutide, Retatrutide, Retatrutide

Primary endpoint: Change from Baseline in Weekly Average Pain Intensity-Numeric Rating Scale (API-NRS) Score [Time Frame: Baseline, up to 72 weeks], Percent Change from Baseline in Body Weight [Time Frame: Baseline, up to 72 weeks]

Source: https://euclinicaltrials.eu/ctis-public/view/2024-517431-43-00